EU clinical trial 2022-502201-16-00: A prospective, open-label, multicenter phase-II-trial to evaluate the efficacy and safety of a sequential regimen of Bendamustine followed by Obinutuzumab (GA101), Zanubrutinib (BGB-3111) and Venetoclax (ABT-199) in patients with relapsed/refractory CLL - (CLL2-BZAG)
Protocol code: CLL2-BZAG
Sponsor: University Of Cologne (Educational Institution). Phase: Therapeutic exploratory (Phase II). Countries: Germany (ongoing, recruitment ended).
Therapeutic area(s): Diseases [C] - Neoplasms [C04]
Gender: Female, Male. Age: 18-64 years, 65+ years. Enrolment: 42.
Status: Ongoing, recruitment ended. Start date (EU): 2020-09-30. Decision date: 2024-06-03. Results received: No. Last updated: 2026-06-17.

Condition(s): Relapsed/refractory chronic lymphocytic leukemia
Product: Venclexta, Venclyxto, BENDAMUSTINE HYDROCHLORIDE, Zanubrutinib, Venclexta, Venclyxto, Venclexta, Venclyxto, Gazyvaro 1,000 mg concentrate for solution for infusion.

Primary endpoint: Negativity rate of minimal residual disease (MRD) in peripher-al blood (PB) measured by multi-color flow cytometry at final restaging (RE) at the end of induction treatment (12 weeks after the start of the last induction cycle)
Endpoint(s): Overall response rate (ORR) according to iwCLL criteria at RE 12 weeks after the start of the last cycle of induction ther-apy including all patients achieving: - a complete response (CR), - CR with incomplete recovery of the bone marrow (CRi), or - a partial response (PR), CR/CRi rate at RE 12 weeks after the start of the last cycle of induction therapy, Safety parameters: Type, frequency, severity, and relation-ship to study treatment of - adverse events (AE), - serious adverse events (SAE) and - adverse events of particular/special interest (AEPI/AESI), MRD in PB measured by 4-color flow cytometry to guide the duration of maintenance therapy at: - RE 12 weeks after the start of the last cycle of induc-tion therapy in all patients responding to study treat-ment and - every 12 weeks (= approx. 3 months) during the maintenance phase - every 24 weeks (= approx. 6 months) during the fol-low-up, and MRD in PB measured by 4-color flow cytometry for the assessment of the kinetics of response to the different treat-ment phases at: - screening/baseline - staging after debulking (if applicable) - before start with zanubrutinib (cycle 2, d1) - before start with venetoclax (cycle 3, d1) - interim staging (after 3 induction cycles) - initial response assessment (after 6 induction cycles), MRD in bone marrow measured by 4-color flow cytometry op-tionally in patients with (clin.) CR/CRi (or PR almost fulfilling CR criteria, e.g. with residual splenomegaly) 12 weeks after achievement of MRD negativity in PB, Best response rate (BRR) until 6 months after RE, ORR after debulking, ORR after end of maintenance treatment, Progression-free survival (PFS), Event-free survival (EFS), Overall survival (OS), Duration of response in patients with - a complete response (CR), - a CR with incomplete recovery of the bone marrow (CRi), - a partial response (PR), Treatment-free survival (TFS) and time to next CLL treatment (TTNT)

Source: https://euclinicaltrials.eu/ctis-public/view/2022-502201-16-00